EU clinical trial 2024-517356-35-00: A Phase IIa Double-Blind, Randomized, Parallel-Arm, Placebo-Controlled Trial To Investigate The Effects Of Three Dose Levels Of CIT-013 On Disease Activity In Patients With Moderately Active Rheumatoid Arthritis.
Protocol code: CITRYLL002-Citydream
Sponsor: Citryll B.V. (Pharmaceutical company). Phase: Therapeutic exploratory (Phase II). Countries: Netherlands (ongoing, recruitment ended), Poland (ongoing, recruitment ended), Belgium (ongoing, recruitment ended), Germany (ongoing, recruitment ended), Spain (ongoing, recruitment ended).
Therapeutic area(s): Diseases [C] - Immune System Diseases [C20]
Gender: Female, Male. Age: 18-64 years, 65+ years. Enrolment: 88.
Status: Ongoing, recruitment ended. Start date (EU): 2025-07-29. Decision date: 2025-07-11. Results received: No. Last updated: 2026-04-15.
Decision dates by country: DE: 2025-07-16, PL: 2025-07-14, BE: 2025-07-15, NL: 2025-07-11, ES: 2025-07-16

Condition(s): Moderately Active Rheumatoid Arthritis
Product: 0.9% w/v Sodium Chloride Injection BP, CIT-013

Primary endpoint: The primary endpoint is the mean change in DAS28-CRP, from baseline to day 43, of CIT-013 the 50 mg CIT-013 and 100 mg CIT-013 arms pooled, compared to placebo.
Endpoint(s): Frequency and severity of treatment-emergent adverse events (TEAE) throughout the trial period, including clinically relevant findings., 2.1. Mean change in DAS28-CRP, from baseline to day 43, per arm of the originally assigned treatment. 2.2. Mean change in DAS28-CRP, from baseline to day 85, per arm of the originally assigned treatment., 3.1. Proportion of ACR20, ACR50, ACR707 responders, from baseline to day 43, per arm of the originally assigned treatment. 3.2. Proportion of ACR20, ACR50, ACR70 responders, from baseline to day 85, per arm of the originally assigned treatment., 3.3. Proportion of participants reaching low disease activity, defined as DAS28-CRP equal or less than 3.2, from baseline to day 43 and day 85, per arm of the originally assigned treatment. 3.4. Proportion of participants reaching disease remission, defined as DAS28-CRP less than 2.6, from baseline to day 43 and day 85, per arm of the originally assigned treatment., 3.5. Mean change in Simplified Disease Activity Index for RA (SDAI) and Clinical Disease Activity Index (CDAI) scores, from baseline to day 43, per arm of the originally assigned treatment. 3.6. Mean change in SDAI and CDAI scores, from baseline to day 85, per arm of the originally assigned treatment., 4.1. Mean change in Health Assessment Questionnaire Disability Index (HAQDI), from baseline to day 43, per arm of the originally assigned treatment. 4.2. Mean change in HAQDI scores, from baseline to day 85, per arm of the originally assigned treatment., 5.1. Pharmacokinetic (PK) levels throughout the trial, per arm of the originally assigned treatment.

Source: https://euclinicaltrials.eu/ctis-public/view/2024-517356-35-00